EU clinical trial 2022-501997-20-00: A Phase 1/2, Global, Open-Label, Extension Study to Evaluate the Long-Term Safety and Clinical Activity of mRNA-3705 in Participants Previously Enrolled in Other Clinical Studies of mRNA-3705.
Protocol code: mRNA-3705-P101-EXT
Sponsor: Moderna Inc. (Pharmaceutical company). Phase: Phase I and Phase II (Integrated)- First administration to humans. Countries: Netherlands (ongoing, recruiting), France (ongoing, recruiting), Spain (ongoing, recruiting).
Therapeutic area(s): Phenomena and Processes [G] - Metabolism [G03]
Gender: Female, Male. Age: 0-17 years, 18-64 years. Enrolment: 26.
Status: Ongoing, recruiting. Start date (EU): 2023-12-01. Decision date: 2023-09-20. Results received: No. Last updated: 2026-07-24.
Decision dates by country: ES: 2024-07-11, FR: 2024-07-05, NL: 2023-09-20

Condition(s): participants with isolated methylmalonic acidemia (MMA) due to methylmalonyl-coenzyme A mutase (MUT) deficiency
Product: PARACETAMOL, FEXOFENADINE HYDROCHLORIDE, PARACETAMOL, DEXAMETHASONE, mRNA-3705, SODIUM CHLORIDE SOLUTION 0.9%, DIPHENHYDRAMINE HYDROCHLORIDE, PARACETAMOL, IBUPROFEN, FAMOTIDINE, PARACETAMOL, HYDROXYZINE HYDROCHLORIDE, CETIRIZINE DIHYDROCHLORIDE, CETIRIZINE DIHYDROCHLORIDE, DEXAMETHASONE PHOSPHATE, IBUPROFEN

Primary endpoint: Incidence and severity of TEAEs, including study drug-related and not related TEAEs, AESIs, SAEs, and TEAEs leading to treatment discontinuation
Endpoint(s): Percentage change in plasma methylmalonic acid and 2-MC levels (primary biomarkers) from baseline, Predose and postdose hMUT mRNA and SM-86 levels, Changes in MDE frequency pretreatment and post-treatment: Annualized MDE rate, Frequency and duration of HCRU visits, Annualized frequency of MMA- related hospitalizations, Annualized frequency of MMA- related healthcare visits, Presence and titers of anti-PEG and anti-hMUT antibodies, Changes in PedsQL™ measurements, Changes in IGA-I, IGA-S, and EQ-5D-5L/Y

Source: https://euclinicaltrials.eu/ctis-public/view/2022-501997-20-00